EU clinical trial 2023-509808-15-00: Comparative Bioavailability of Lisdexamfetamine Dimesylate 70 mg in Healthy Subjects Under Fasting Conditions
Protocol code: BLCL-LIS-PIL01
Sponsor: Pharmaplot P.C. (Pharmaceutical company). Phase: Human Pharmacology (Phase I)- Bioequivalence Study. Countries: Portugal (ended).
Therapeutic area(s): Not possible to specify
Gender: Female, Male. Age: 18-64 years. Enrolment: 12.
Status: Ended. Start date (EU): 2024-04-29. End date (EU): 2024-05-29. Decision date: 2024-03-13. Results received: No. Last updated: 2024-05-14.

Condition(s): No medical condition.

Source: https://euclinicaltrials.eu/ctis-public/view/2023-509808-15-00